EU clinical trial 2023-503390-38-00: Safety, tolerability and effect of DLX-001 in healthy volunteers
Sponsor: Delix Therapeutics Inc. (Pharmaceutical company). Phase: Human Pharmacology (Phase I)- First administration to humans. Countries: Netherlands (ended).
Therapeutic area(s): Psychiatry and Psychology [F] - Mental Disorders [F03]
Gender: Female, Male. Age: 18-64 years. Enrolment: 106.
Status: Ended. Start date (EU): 2023-04-14. End date (EU): 2024-08-16. Decision date: 2023-04-12. Results received: No. Last updated: 2024-06-27.

Condition(s): Unipolar depression (UD)

Source: https://euclinicaltrials.eu/ctis-public/view/2023-503390-38-00